EU clinical trial 2023-510017-26-00: A Double-Blind, Randomized, Three-arm, Active-Controlled, Parallel-Group, Phase 1 Study Evaluating Pharmacokinetic Similarity of Three Formulations of Pembrolizumab (CT-P51, EU-approved Keytruda, and US-licensed Keytruda) as Adjuvant Therapy in Patients with Completely Resected Stage IIB, IIC, and III Melanoma
Protocol code: CT-P51 1.1
Sponsor: Celltrion Inc. (Pharmaceutical company). Phase: Human Pharmacology (Phase I)- First administration to humans. Countries: Spain (ongoing, recruitment ended), Romania (ongoing, recruitment ended), Slovenia (ended), Italy (ended), Poland (ongoing, recruitment ended), Croatia (not authorised).
Therapeutic area(s): Diseases [C] - Skin and Connective Tissue Diseases [C17]
Gender: Female, Male. Age: 18-64 years, 65+ years. Enrolment: 83.
Start date (EU): 2024-10-02. Decision date: 2024-08-23. Results received: No. Last updated: 2026-04-20.
Decision dates by country: HR: 2024-09-05, IT: 2024-08-27, SI: 2024-08-23, PL: 2024-08-27, ES: 2024-08-23, RO: 2024-09-06

Condition(s): Completely Resected Stage IIB, IIC, and III Melanoma

Source: https://euclinicaltrials.eu/ctis-public/view/2023-510017-26-00